EU clinical trial 2023-510429-14-00: Beamion PANTUMOR-1: A Phase II, multicentre, multicohort, open-label trial to evaluate the efficacy and safety of oral zongertinib (BI 1810631) for the treatment of selected HER2-mutated or overexpressed/amplified solid tumours
Protocol code: 1479-0009
Sponsor: Boehringer Ingelheim International GmbH, Boehringer Ingelheim Espana S.A. (Pharmaceutical company). Phase: Therapeutic exploratory (Phase II). Countries: Netherlands (ongoing, recruiting), Italy (ongoing, recruiting), Norway (ongoing, recruiting), Germany (ongoing, recruiting), France (ongoing, recruiting), Belgium (ongoing, recruiting), Spain (ongoing, recruiting).
Therapeutic area(s): Diseases [C] - Neoplasms [C04]
Gender: Female, Male. Age: 18-64 years, 65+ years. Enrolment: 108.
Status: Ongoing, recruiting. Start date (EU): 2024-10-22. Decision date: 2024-09-09. Results received: No. Last updated: 2026-02-23.
Decision dates by country: IT: 2024-09-11, NL: 2024-09-16, NO: 2024-09-09, ES: 2024-09-09, BE: 2024-09-12, FR: 2024-09-13, DE: 2024-09-11

Condition(s): HER2-mutated or overexpressed/amplified solid tumours
Product: BI 1810631

Primary endpoint: Proportion of patients with objective response (OR)
Endpoint(s): Duration of objective response (DOR), Progression free survival (PFS), Disease control (DC), Overall survival (OS), Occurrence of treatment-emergent adverse events (AEs), Change from baseline to Week 48 or PD by central independent review, if earlier, in the European Organisation for Research and Treatment of Cancer, (EORTC QLQ-C30)

Source: https://euclinicaltrials.eu/ctis-public/view/2023-510429-14-00